EU clinical trial 2024-512578-83-00: A phase 1 study to assess the mass balance, pharmacokinetics, metabolism, and excretion of GSBR-1290, containing a microtracer dose of [14C] GSBR-1290, in healthy participants
Protocol code: GSBR-1290-07
Sponsor: Structure Therapeutics Inc. (Pharmaceutical company). Phase: Human Pharmacology (Phase I)- Other. Countries: Netherlands (ended).
Therapeutic area(s): Diseases [C] - Hormonal diseases [C19]
Gender: Female, Male. Age: 18-64 years. Enrolment: 8.
Status: Ended. Start date (EU): 2024-06-24. End date (EU): 2024-09-09. Decision date: 2024-06-14. Results received: No. Last updated: 2024-10-01.

Condition(s): Not applicable - Healthy volonteers

Source: https://euclinicaltrials.eu/ctis-public/view/2024-512578-83-00